EU clinical trial 2024-517143-31-00: A Phase 2, Multicenter, Randomized, Double-blind, Placebo-controlled Study to Evaluate the Safety and Efficacy of ABBV-CLS-628 in Adult Subjects with Autosomal Dominant Polycystic Kidney Disease (ADPKD)
Protocol code: M25-147
Sponsor: Calico Life Sciences LLC (Pharmaceutical company). Phase: Therapeutic exploratory (Phase II). Countries: Spain (ongoing, recruitment ended), Portugal (ongoing, recruitment ended), Germany (ongoing, recruitment ended), Netherlands (ongoing, recruitment ended), France (ongoing, recruitment ended), Italy (ongoing, recruitment ended), Belgium (ongoing, recruitment ended).
Therapeutic area(s): Diseases [C] - Nervous System Diseases [C10]
Gender: Female, Male. Age: 18-64 years. Enrolment: 98.
Status: Ongoing, recruitment ended. Start date (EU): 2025-07-18. Decision date: 2025-07-07. Results received: No. Last updated: 2026-05-26.
Decision dates by country: ES: 2025-07-07, NL: 2025-07-16, PT: 2025-07-09, IT: 2025-07-17, BE: 2025-07-07, FR: 2025-07-07, DE: 2025-07-07

Condition(s): Autosomal Dominant Polycystic Kidney Disease
Product: ABBV-CLS-628, Placebo for ABBV-CLS-628

Primary endpoint: Cumulative rate of change from baseline in TKV by MRI at Week 96.
Endpoint(s): Absolute change in eGFR from baseline at Week 96., Cumulative rate of change from baseline in TKV by MRI at Week 48.

Source: https://euclinicaltrials.eu/ctis-public/view/2024-517143-31-00